EU clinical trial 2024-512758-62-00: [18F]-Fludarabine PET/MR Imaging for the Assessment of Newly-diagnosed Primary Central Nervous System (CNS) Lymphoma : a Pilot PET-MRI Study
Protocol code: P160407
Sponsor: Assistance Publique Hopitaux De Paris (Hospital/Clinic/Other health care facility). Phase: Phase I and Phase II (Integrated)- Other. Countries: France (ended).
Therapeutic area(s): Diseases [C] - Nervous System Diseases [C10]
Gender: Female, Male. Age: 18-64 years, 65+ years. Enrolment: 16.
Status: Ended. Start date (EU): 2023-12-18. End date (EU): 2024-12-05. Decision date: 2024-11-08. Results received: No. Last updated: 2024-11-08.

Condition(s): Patients with newly diagnosed primary central nervous system lymphoma naïve to surgery, radiotherapy or chemotherapy
Product: GADOTERIC ACID, [18F]fludarabine

Primary endpoint: Standardized measurement of tumor uptake of [18F]-Fludarabine (Standard uptake value or SUV) in tumor lesions, relative to SUV of healthy tissue quantified on PET images superimposed on MRI.
Endpoint(s): Cerebral distribution and activity-time curves for [18F]-Fludarabine, Tumor/healthy tissue contrast on PET-[18F]-Fludarabine, Tumor SUVmax, tumor/healthy tissue ratio in PET- [18F]-FDG, lesion volumes in 3D T1 MRI with Gadolinium, Apparent diffusion coefficient (ADC) in diffusion MRI, Tumor perfusion in perfusion MRI, Metabolite ratios in spectroscopy, histological or cytological diagnosis

Source: https://euclinicaltrials.eu/ctis-public/view/2024-512758-62-00